EU clinical trial 2024-516325-31-01: Placebo-controlled double-blind trial of the analgesic effect and safety of clonidine in patients after major abdominal surgery
Sponsor: Esbjerg Og Grindsted Sygehus (Hospital/Clinic/Other health care facility). Phase: Therapeutic use (Phase IV). Countries: Denmark (authorised, recruitment pending).
Therapeutic area(s): Analytical, Diagnostic and Therapeutic Techniques and Equipment [E] - Anesthesia and Analgesia [E03]
Gender: Female, Male. Age: 18-64 years, 65+ years. Enrolment: 182.
Status: Authorised, recruitment pending. Decision date: 2024-12-17. Results received: No. Last updated: 2024-12-17.

Condition(s): Trial participants are having colectomy due to cancer
Product: CLONIDINE

Primary endpoint: Use of morphine 24 hours post-operatively
Endpoint(s): VAS/NRS (pain scores), Qestionnaires, QST (Quantitative Sensory Testing), ANS (BP, ECG, HR, Sat, Tp, Pupil reaction), Certain genetic profile (CYP2D6, OPRM and COMT sequenced. SNPs of ABCB1 and rs2952768/CREB1 and ncRNA), Blood samples (concentrations of clonidine, morphine, morphine-3-glucoronide, morphine-6-glucoronide), Demographics, physical, medical, laboratory data, Physical examination.

Source: https://euclinicaltrials.eu/ctis-public/view/2024-516325-31-01